EU clinical trial 2025-521981-90-00: A Study Testing the Investigational Drug XmAb541 in people with Advanced Cancer
Protocol code: XmAb541-01
Sponsor: Xencor Inc. (Pharmaceutical company). Phase: Human Pharmacology (Phase I)- First administration to humans. Countries: Spain (authorised, recruitment pending), France (authorised, recruitment pending), Belgium (authorised, recruitment pending), Denmark (authorised, recruitment pending).
Therapeutic area(s): Diseases [C] - Neoplasms [C04]
Gender: Female, Male. Age: 18-64 years, 65+ years. Enrolment: 70.
Status: Authorised, recruitment pending. Decision date: 2025-10-27. Results received: No. Last updated: 2026-07-31.
Decision dates by country: ES: 2025-10-30, FR: 2025-11-03, DK: 2025-10-27, BE: 2025-10-29

Condition(s): Advanced Solid Tumors

Source: https://euclinicaltrials.eu/ctis-public/view/2025-521981-90-00